EU clinical trial 2024-515356-21-00: GFM-EPO-PRETAR: A randomized trial testing early versus late onset of EPO alfa treatment in lower risk MDS with non RBC transfusion dependent anemia and without del 5q
Protocol code: GFM-EPO-PRETAR
Sponsor: Groupe Francophone Des Myelodysplasies (Patient organisation/association). Phase: Therapeutic confirmatory (Phase III). Countries: France (ended).
Therapeutic area(s): Diseases [C] - Hemic and Lymphatic Diseases [C15]
Gender: Female, Male. Age: 18-64 years, 65+ years. Enrolment: 124.
Status: Ended. Start date (EU): 2018-04-17. End date (EU): 2024-10-29. Decision date: 2024-09-24. Results received: Yes. Last updated: 2024-09-24.

Condition(s): Adult subject (18 years of age older) with low or intermediate-1 IPSS risk MDS with transfusions independent anemia
Product: EPREX 40000 UI/ml, solution injectable en seringue préremplie

Primary endpoint: Comparison of the time to RBC transfusion dependence between patients with early onset of EPO ALFA (at inclusion) and patients with delayed onset of EPO ALFA (at the threshold chosen for RBC transfusion)
Endpoint(s): IWG 2006 erythroid response and duration, QoL, OS, Molecular biology corrélations

Source: https://euclinicaltrials.eu/ctis-public/view/2024-515356-21-00